EU clinical trial 2022-501477-40-00: A study to learn the effects of ripretinib (study drug) on how midazolam behaves in the body of people with advanced gastrointestinal stromal tumor
Sponsor: Deciphera Pharmaceuticals Inc. (Pharmaceutical company). Phase: Human Pharmacology (Phase I)- Other. Countries: Netherlands (ongoing, recruitment ended), Spain (ongoing, recruitment ended), Italy (ongoing, recruitment ended).
Therapeutic area(s): Diseases [C] - Neoplasms [C04]
Gender: Female, Male. Age: 18-64 years, 65+ years. Enrolment: 22.
Status: Ongoing, recruitment ended. Start date (EU): 2024-06-25. Decision date: 2023-08-28. Results received: No. Last updated: 2025-11-21.
Decision dates by country: ES: 2023-09-01, NL: 2023-08-31, IT: 2023-08-28

Condition(s): Advanced Gastrointestinal Stromal Tumor

Source: https://euclinicaltrials.eu/ctis-public/view/2022-501477-40-00